EU clinical trial 2023-510288-37-00: A Study to Investigate the Safety and Tolerability of Ziftomenib Combinations in Patients with Relapsed/Refractory Acute Myeloid Leukemia
Protocol code: KO-MEN-008
Sponsor: Kura Oncology Inc. (Pharmaceutical company). Phase: Human Pharmacology (Phase I)- Other. Countries: Italy (ongoing, recruiting), Spain (ongoing, recruiting), Germany (ended).
Therapeutic area(s): Diseases [C] - Neoplasms [C04]
Gender: Female, Male. Age: 18-64 years, 65+ years. Enrolment: 30.
Start date (EU): 2024-11-01. Decision date: 2024-08-22. Results received: No. Last updated: 2026-04-20.
Decision dates by country: ES: 2024-08-22, IT: 2024-08-26, DE: 2024-08-27

Condition(s): Relapsed and/or refractory Acute Myeloid Leukemia

Source: https://euclinicaltrials.eu/ctis-public/view/2023-510288-37-00